EU clinical trial 2024-513222-30-00: 2-year, Multicentre, Open-label, Flexible-dose Study to Evaluate the Safety and Tolerability of Cariprazine in the Treatment of Adolescent Patients with Schizophrenia
Protocol code: RGH-188-203
Sponsor: Gedeon Richter Plc. (Pharmaceutical company). Phase: Therapeutic confirmatory (Phase III). Countries: Romania (ended), Bulgaria (ended), Germany (ended).
Therapeutic area(s): Diseases [C] - Nervous System Diseases [C10]
Gender: Female, Male. Age: 0-17 years. Enrolment: 39.
Status: Ended. Start date (EU): 2020-02-20. End date (EU): 2026-07-22. Decision date: 2024-07-16. Results received: No. Last updated: 2026-01-16.
Decision dates by country: DE: 2024-07-22, BG: 2024-07-16, RO: 2024-07-30

Condition(s): Adolescent patient (13-17 years of age) with Schizophrenia
Product: Cariprazine 0.5 mg capsules, hard, Reagila 6 mg hard capsules, Reagila 4.5 mg hard capsules, Reagila 3 mg hard capsules, Reagila 1.5 mg hard capsules

Primary endpoint: Primary Outcome Measures: adverse events, clinical laboratory assessments including HbA1c, prolactin, FSH and LH, menstrual cycle assessment, vital signs, weight, physical examination, ECG, C-SSRS, CDSS, AIMS, BARS, SAS, UKU and Tanner staging
Endpoint(s): "Additional Outcome Measures: Effectiveness measures: PANSS, CGI-S, CGI-I, C-GAS, CDR system Health-related outcome measures: CGSQ, PQ-LES-Q Per p Additional Outcome Measures: Effectiveness measures: PANSS, CGI-S, CGI-I, C-GAS, CDR system Health-related outcome measures: CGSQ, PQ-LES-Q Per p"

Source: https://euclinicaltrials.eu/ctis-public/view/2024-513222-30-00